EU clinical trial 2023-505273-33-00: ENCORE - A Randomized, Double-Blind, Placebo-Controlled, Active Comparator, Multicenter Study to Evaluate the Efficacy and Safety of an Amikacin Liposome Inhalation Suspension (ALIS)-Based Regimen in Adult Subjects with Newly Diagnosed Nontuberculous Mycobacterial (NTM) Lung Infection Caused by Mycobacterium avium Complex (MAC)
Protocol code: INS-416
Sponsor: Insmed Inc. (Pharmaceutical company). Phase: Therapeutic confirmatory (Phase III). Countries: Denmark (ended), Spain (ended), Hungary (ended), Austria (ended), Belgium (ended), Germany (ended), Poland (ended), Italy (ended), France (ended), Portugal (ended), Greece (ended).
Therapeutic area(s): Diseases [C] - Respiratory Tract Diseases [C08]
Gender: Female, Male. Age: 18-64 years, 65+ years. Enrolment: 383.
Status: Ended. Start date (EU): 2021-02-15. End date (EU): 2025-12-16. End date: 2025-12-17. Decision date: 2024-05-13. Results received: No. Last updated: 2025-06-20.
Decision dates by country: DE: 2024-05-15, HU: 2024-05-15, AT: 2024-05-21, IT: 2024-05-20, PL: 2024-05-20, GR: 2024-07-24, BE: 2024-05-22, FR: 2024-06-11, ES: 2024-05-14, DK: 2024-05-14, PT: 2024-05-13

Condition(s): "Adult Subjects with Newly Diagnosed Nontuberculous Mycobacterial (NTM) Lung Infection Caused by Mycobacterium avium Complex (MAC)"
Product: EMB-Fatol® 100 mg, Tabletten, The placebo for Amikacin Liposome for Inhalation Suspension drug product is a white translucent suspension consisting of dipalmitoylphosphatidylcholine (DPPC) and cholesterol, which are dispersed in 1.5% (w/w) sodium chloride solution. The placebo is filled into the same container closure system of the drug product, Azithromycin-ratiopharm 250mg Filmtabletten, Azithromycin STADA® 250 mg Filmtabletten, Azithromycin AL 250 mg Filmtabletten, Azitromicina Teva 250 mg comprimidos recubiertos con película EFG., EMB-Fatol 400 mg, Filmtabletten, Azithromycin HEXAL 250 mg Filmtabletten, ARIKAYCE liposomal 590 mg nebuliser dispersion

Primary endpoint: Change from Baseline to Month 13 in respiratory symptom score
Endpoint(s): To evaluate the efficacy of ALIS + background regimen compared to ELC + background regimen on the following: • Proportion of subjects achieving durable culture conversion at Month 15, • Change from Baseline to Month 13 in fatigue symptom score, • Proportion of subjects achieving culture conversion by Month 12 (negative cultures for MAC at Month 11 and Month 12), • Proportion of subjects achieving culture conversion by Month 6 (negative cultures for MAC at Month 5 and Month 6), • Proportion of subjects achieving culture conversion at any time during treatment (first 2 consecutive negative cultures) of Baseline to EOT assessments, • Time to culture conversion (first of 2 consecutive negative cultures) of Baseline to EOT assessments, • Time to first negative culture of Baseline to EOT assessments, • Proportion of subjects who develop a MAC isolate with amikacin MIC ≥ 128 µg/mL at more than 1 visit at any timepoint during the study, • Proportion of subjects who achieved culture conversion and subsequently have at least 1 MAC positive culture in agar media or positive cultures in broth media in at least 2 consecutive visits that is the same species and genome as that cultured at Screening/Baseline., • Proportion of subjects who achieved culture conversion and subsequently have at least 1 MAC positive culture in agar media or positive cultures in broth media in at least 2 consecutive visits that is different than that cultured at Screening/Baseline (different species or same species but different genome)., • Proportion of subjects meeting the within-subject meaningful change threshold as reflected in the change in respiratory symptom scores computed from Baseline to Month 13, • Incidence and severity of AEs and TEAEs and other safety variables (eg, vital signs, physical examination, clinical laboratory values) from Baseline through the EOS, Proportion of subjects achieving cultureconversion by Month 13 (negative cultures for MAC at Month 12 and Month 13)

Source: https://euclinicaltrials.eu/ctis-public/view/2023-505273-33-00